EU clinical trial 2024-513614-36-00: Phase 1/2 Trial to determine the safety and efficacy of Extracorporeal photopheresis as treatment for steriod-refractory immune related adverse events after immune checkpoint inhibitor therapy - ECIR
Protocol code: 1125-ECIR
Sponsor: Medical Center - University Of Freiburg (Hospital/Clinic/Other health care facility). Phase: Phase I and Phase II (Integrated)- Other. Countries: Germany (ended).
Therapeutic area(s): Diseases [C] - Neoplasms [C04]
Gender: Female, Male. Age: 18-64 years, 65+ years. Enrolment: 30.
Status: Ended. Start date (EU): 2022-07-27. End date (EU): 2025-10-23. Decision date: 2024-08-02. Results received: No. Last updated: 2024-08-02.

Condition(s): Immune related adverse events induced by treatment with immunotherapy
Product: UVADEX 20 Mikrogramm/ml Lösung zur Modifikation einer Blutfraktion

Primary endpoint: To evaluate the rate of treatment-related adverse events (AEs) and serious adverse events (SAEs) in patients treated with ECP for immunecheckpoint inhibitor-induced colitis, pneumonitis, hepatitis or dermatitis. A positive result from the study is defined as ≤50% of the patients developing a treatment-related SAE.
Endpoint(s): Key secondary endpoints: • To evaluate the investigator-assessed objective response rate (ORR) to treatment after 6 and 12 weeks of ECP therapy The response criteria for each organ are described in chapter 6.2. • To assess time to response • To assess the duration of investigator-assessed clinical response • To assess overall survival (OS) at 1 year after end of ECP treatment • To measure the time to complete discontinuation of other immunosuppressive therapy

Source: https://euclinicaltrials.eu/ctis-public/view/2024-513614-36-00